EU clinical trial 2025-521595-55-00: Investigating how NNC0487-0111 regulates insulin in adults with type 2 diabetes
Protocol code: NN9490-8153
Sponsor: Novo Nordisk A/S (Pharmaceutical company). Phase: Human Pharmacology (Phase I)- Other. Countries: Germany (ongoing, recruiting).
Therapeutic area(s): Diseases [C] - Nutritional and Metabolic Diseases [C18]
Gender: Female, Male. Age: 18-64 years, 65+ years. Enrolment: 80.
Status: Ongoing, recruiting. Start date (EU): 2026-03-25. Decision date: 2026-03-09. Results received: No. Last updated: 2026-06-18.

Condition(s): Type 2 Diabetes

Source: https://euclinicaltrials.eu/ctis-public/view/2025-521595-55-00